EU clinical trial 2023-507328-22-00: A Phase 2, Open-Label, Adaptive, Dose-Ranging Study with Long-Term Extension to Evaluate the Safety, Tolerability, Efficacy, and Pharmacokinetics of Intra-articular AMB-05X Injections in Subjects with Tenosynovial Giant Cell Tumor
Protocol code: AMB-051-07
Sponsor: Ammax Bio Inc. (Pharmaceutical company). Phase: Therapeutic exploratory (Phase II). Countries: Netherlands (ended).
Therapeutic area(s): Diseases [C] - Congenital, Hereditary, and Neonatal Diseases and Abnormalities [C16]
Gender: Female, Male. Age: 18-64 years, 65+ years. Enrolment: 20.
Status: Ended. Start date (EU): 2022-12-20. End date (EU): 2024-04-26. End date: 2024-05-09. Decision date: 2023-10-06. Results received: Yes. Last updated: 2024-01-26.

Condition(s): Tenosynovial Giant Cell Tumor
Product: AMB-05X

Primary endpoint: Proportion of subjects who achieve an objective response (OR) (objective response rate [ORR]) by central radiology review (which includes both complete response [CR] and partial response [PR]) per Response Evaluation Criteria in Solid Tumors Version 1.1 (RECIST v1.1) at Week 24 for Part 1, Frequency and severity of reported treatment-emergent adverse events (TEAEs)
Endpoint(s): Proportion of subjects who achieve an OR (ORR) by central radiology review (which includes both complete response [CR] and partial response [PR]) per RECIST v1.1 (for Part 2 only), Proportion of subjects who were re-treated with AMB-05X (ie, subjects entering the study from Study AMB-051-01) who achieve an OR (ORR) by central radiology review (which includes both CR and PR) per RECIST v1.1 (for Part 2 only), Proportion of subjects who achieve an OR (which includes both CR and PR) per modified RECIST, Proportion of subjects who achieve an OR per tumor volume score (TVS), a TGCT-specific method that calculates tumor volume as a percentage of the estimated maximally distended synovial cavity, Median duration of response per RECIST v1.1, modified RECIST, and TVS, Time to response (TTR) per RECIST v1.1, modified RECIST, and TVS, Mean change from Baseline in joint range of motion (ROM) score, Mean change from Baseline in the Patient-Reported Outcomes Measurement Information System (PROMIS) Physical Function score, Mean change from Baseline in Worst Stiffness Numeric Rating Scale (NRS) score, Percentage of subjects who respond with a decrease of at least 30% in mean Brief Pain Inventory (BPI) score from Baseline, Mean change from Baseline in BPI score, Mean change from Baseline in PROMIS Pain Interference score, Mean change from Baseline in Patient Global Impression of Change (PGIC) in Physical Functioning for capacity to perform everyday tasks, Mean change from Baseline in PGIC in TGCT-related stiffness score, Mean change from Baseline in Worst Pain NRS score, Mean change from Baseline in EuroQol 5-dimension 5-level (EQ-5D-5L) health assessment, Serum and synovial AMB-05X levels, Serum and synovial antidrug antibody (ADA) levels against AMB-05X, Serum and synovial CSF1 levels

Source: https://euclinicaltrials.eu/ctis-public/view/2023-507328-22-00